EU clinical trial 2024-516530-36-00: A Randomized Phase III, Two-Arm Trial of Paclitaxel/Carboplatin/Maintenance Letrozole Versus Letrozole Monotherapy in Patients with Stage II-IV, Primary Low-Grade Serous Carcinoma of the Ovary or Peritoneum.
Protocol code: NRG-GY019
Sponsor: Cancer Trials Ireland (Patient organisation/association). Phase: Therapeutic confirmatory (Phase III). Countries: Ireland (ongoing, recruitment ended).
Therapeutic area(s): Diseases [C] - Neoplasms [C04]
Gender: Female. Age: 18-64 years, 65+ years. Enrolment: 20.
Status: Ongoing, recruitment ended. Start date (EU): 2025-01-08. Decision date: 2024-09-03. Results received: No. Last updated: 2025-10-14.

Condition(s): low-grade serous carcinoma of the ovary or peritoneum
Product: Femara 2.5 mg film-coated tablets, Cisplatin 1 mg/ml Concentrate for Solution for Infusion, Anastrozole 1mg film-coated tablets, Docetaxel Pfizer 10 mg/mL concentrate for solution for infusion, Paclitaxel 6 mg/ml Concentrate for Solution for Infusion, Exemestane 25 mg Film-coated Tablets, Carboplatin 10 mg/ml Concentrate for Solution for Infusion, Abraxane 5 mg/ml powder for dispersion for infusion.

Primary endpoint: The primary efficacy endpoint is Progression Free Survival (PFS). PFS is defined as the time (in months) from the randomized treatment assignment to documentation of disease progression (RECIST 1.1) or death from any cause, whichever comes first., The study includes two interim analyses. At 20% information time, a futility analysis will be conducted. At 40% information time, both efficacy and futility will be assessed. The PFS comparison will be assessed at the second interim and final analyses using a logrank test stratified by country and residual disease status., Full analysis will be performed after the date on which the last participant was examined or received an intervention/treatment to collect final data for the primary outcome measures, secondary outcome measures, and adverse events.
Endpoint(s): Toxicity, Objective Tumour Response, Overall Survival, Adherence to Letrozole Maintenance Therapy, The study includes two interim analyses. At 20% information time, a futility analysis will be conducted. At 40% information time, both efficacy and futility will be assessed., Full analysis will be performed after the date on which the last participant was examined or received an intervention/treatment to collect final data for the primary outcome measures, secondary outcome measures, and adverse events.

Source: https://euclinicaltrials.eu/ctis-public/view/2024-516530-36-00